EU clinical trial 2025-522403-17-00: A Phase 3, Randomised, Double-Blind, Placebo-Controlled, Parallel Group, Multicentre Study With a Double-Blind Extension Evaluating Efficacy and Safety of Lebrikizumab Administered to Adult Patients With Nummular Eczema who are not Adequately Controlled With Topical Corticosteroids or When This Treatment is not Medically Advisable (LUMINE)
Protocol code: M-27501-30
Sponsor: Almirall S.A. (Pharmaceutical company). Phase: Therapeutic confirmatory (Phase III). Countries: Italy (authorised, recruiting), Bulgaria (ongoing, recruiting), Spain (ongoing, recruiting), Germany (ongoing, recruiting), Poland (ongoing, recruiting), France (authorised, recruitment pending).
Therapeutic area(s): Diseases [C] - Skin and Connective Tissue Diseases [C17]
Gender: Female, Male. Age: 18-64 years, 65+ years. Enrolment: 290.
Start date (EU): 2026-04-10. Decision date: 2026-03-23. Results received: No. Last updated: 2026-07-20.
Decision dates by country: BG: 2026-03-30, PL: 2026-04-15, DE: 2026-05-13, IT: 2026-03-24, FR: 2026-07-20, ES: 2026-05-08

Condition(s): Nummular Dermatitis
Product: Ebglyss 250 mg solution for injection in pre-filled syringe, Placebo

Primary endpoint: 1. Percentage of participants achieving endpoint reduction from baseline at Week 24.
Endpoint(s): 1. Percentage of participants with Pruritus NRS ≥4 at baseline achieving a ≥4-point improvement in Pruritus NRS score from baseline at Week 24, 2. Absolute change from baseline in DLQI to Week 24.

Source: https://euclinicaltrials.eu/ctis-public/view/2025-522403-17-00